EU clinical trial 2023-505865-94-00: A Phase I/II, Open-Label, Multi-Cohort Study to Evaluate the Efficacy and Safety of Cevostamab in Prior B Cell Maturation Antigen-Exposed Patients With Relapsed/Refractory Multiple Myeloma
Protocol code: CO43476
Sponsor: F. Hoffmann-La Roche AG (Pharmaceutical company). Phase: Phase I and Phase II (Integrated)- Other. Countries: Spain (ongoing, recruitment ended), France (ongoing, recruitment ended), Italy (ongoing, recruitment ended), Belgium (ongoing, recruitment ended), Germany (ongoing, recruitment ended).
Therapeutic area(s): Diseases [C] - Neoplasms [C04]
Gender: Female, Male. Age: 18-64 years, 65+ years. Enrolment: 38.
Status: Ongoing, recruitment ended. Start date (EU): 2022-10-26. Decision date: 2024-06-27. Results received: No. Last updated: 2026-03-25.
Decision dates by country: BE: 2024-06-27, FR: 2024-07-02, DE: 2024-07-01, ES: 2024-06-28, IT: 2024-09-10

Condition(s): Relapsed/Refractory Multiple Myeloma
Product: Cevostamab, RoActemra 20 mg/mL concentrate for solution for infusion

Primary endpoint: 1. ORR, defined as the proportion of participants with an objective response [stringent complete response (sCR), complete response (CR), very good partial response (VGPR), or partial response (PR)], based on investigator-assessed response, according to IMWG criteria, 2. Incidence and severity of adverse events, with severity determined according to National Cancer Institute Common Terminology Criteria for Adverse Events (NCI CTCAE) v5.0 and American Society for Transplantation and Cellular Therapy (ASTCT) for CRS and of immune effector cell associated neurotoxicity syndrome (ICANS) grading
Endpoint(s): 1. ORR, defined as the proportion of participants with an objective response based on independent review committee (IRC)-assessed response, 2. Duration of response (DOR), defined as the time from the first occurrence of an objective response until the date of disease progression or death from any cause (whichever occurs first), as determined separately by the IRC and the investigator, 3. Rate of CR or better, defined as the proportion of participants who achieve a response of sCR or CR, as assessed separately by IRC and the investigator, 4. Rate of VGPR or better, defined as the proportion of participants who achieve a response of VGPR or better, as assessed separately by IRC and the investigator, 5. Overall survival (OS), defined as the time from initiation of study treatment to death from any cause, 6. Progression-free survival (PFS), defined as the time from initiation of study treatment to the first occurrence of disease progression, relapse, or death from any cause (whichever occurs first), as assessed separately by IRC and the investigator, 7. Time to first response (for participants who achieve an objective response), defined as time from initiation of study treatment to first achieving an objective response (separate analyses by IRC and investigator), 8. Time to best response (for participants who achieve an objective response), defined as time from initiation of study treatment to achieving the deepest response (separate analyses by IRC and investigator), 9. Proportion of participants experiencing a clinically meaningful improvement in the fatigue domain of the European Organization for Research and Treatment of Cancer (EORTC) Quality of Life Core-30 Questionnaire (QLQC-30) and EORTC QLQ-MY20, 10. Time to deterioration in the fatigue domain of the EORTC QLQ-C30 and/or disease symptoms domain of the EORTC QLQ-MY20, 11. Serum concentration of cevostamab at specified timepoints, 12. Pharmacokinetics (PK) parameters of cevostamab, as data allow, 13. Prevalence of anti-drug antibodies (ADAs) against cevostamab at baseline and incidence of ADAs against cevostamab during the study, 14. CRS outcome following administration of tocilizumab (e.g., time to CRS resolution, doses of tocilizumab administered, relationship between serum concentration or other PK parameters for tocilizumab and pharmacodynamic biomarkers), 15. Relationship between serum concentration or other PK parameters for cevostamab and pharmacodynamic biomarkers, including, but not limited to, cytokine release, T cell number, and T-cell activation state, 16. Relationship between biomarkers in blood, bone marrow biopsies and aspirates, and tumor tissue and efficacy, safety, PK, immunogenicity, or other biomarker endpoints

Source: https://euclinicaltrials.eu/ctis-public/view/2023-505865-94-00